EU clinical trial 2024-513082-39-00: A Phase 3 (Pivotal Stage) Study of NBTXR3 Activated by Investigator’s Choice of Radiotherapy Alone or Radiotherapy in Combination with Cetuximab for Platinum-based Chemotherapy ineligible Elderly Patients with Locally Advanced Head & Neck Squamous Cell Carcinoma
Protocol code: NANORAY-312
Sponsor: Nanobiotix (Pharmaceutical company). Phase: Therapeutic exploratory (Phase II). Countries: Czechia (ended), Greece (ended), Germany (ended).
Therapeutic area(s): Diseases [C] - Neoplasms [C04]
Gender: Female, Male. Age: 18-64 years, 65+ years. Enrolment: 60.
Status: Ended. Start date (EU): 2022-04-26. End date (EU): 2026-01-13. End date: 2026-01-14. Decision date: 2024-11-08. Results received: Yes. Last updated: 2025-01-23.
Decision dates by country: CZ: 2024-11-11, DE: 2024-11-08, GR: 2025-01-23

Condition(s): Locally Advanced Head & Neck Squamous Cell Carcinoma
Product: Erbitux 5 mg/mL solution for infusion

Primary endpoint: PFS: time from randomization to loco-regional recurrence, loco-regional progression, distant progression, or death from any cause, whichever occurs first
Endpoint(s): OS: time from randomization to death from any cause

Source: https://euclinicaltrials.eu/ctis-public/view/2024-513082-39-00